EU clinical trial 2023-510084-35-00: Tocilizumab for Painful Chronic Pancreatitis: A Randomised, Placebo-controlled, Double-blinded, Investigator-initiated Trial (TOPAC trial)
Sponsor: Aalborg University Hospital (Hospital/Clinic/Other health care facility). Phase: Therapeutic exploratory (Phase II). Countries: Denmark (ongoing, recruiting).
Therapeutic area(s): Diseases [C] - Digestive System Diseases [C06]
Gender: Female, Male. Age: 18-64 years, 65+ years. Enrolment: 36.
Status: Ongoing, recruiting. Start date (EU): 2024-05-21. Decision date: 2024-03-25. Results received: No. Last updated: 2024-03-25.

Condition(s): Chronic pancreatitis
Product: Natriumklorid ”B. Braun”, RoActemra 20 mg/mL concentrate for solution for infusion

Primary endpoint: The primary outcome assessment parameter is the total score of the COMPAT-SF questionnaire (31). The primary endpoint is the difference between the tocilizumab and placebo-treated groups in the COMPAT-SF score after 24 weeks.
Endpoint(s): The European Organization for Research and Treatment of Cancer Quality of Life (EORTC-QLQ-C30) questionnaire between treatment groups (tocilizumab vs. placebo) at weeks 12 and 24., The Brief Pain Inventory Short Form (mBPI-SF) pain severity and interference scores between treatment groups (tocilizumab vs. placebo) at weeks 12 and 24., The average daily pain score (registered in the mBPI-SF) between treatment groups (tocilizumab vs. placebo) at week 24., The Patient Global Impression of Change (PGIC) questionnaire between treatment groups (tocilizumab vs. placebo) at week 24., The CP prognosis score (COPPS)-score between treatment groups (tocilizumab vs. placebo) at week 24., Use of analgesics, including opioid-based therapies (type and dose)., Adherence to treatment and frequency of adverse events.

Source: https://euclinicaltrials.eu/ctis-public/view/2023-510084-35-00